EU clinical trial 2024-519014-31-00: Measuring the macro- and microvascular responses to LPS and exenatide
Protocol code: CHDR2418
Sponsor: Centre for Human Drug Research (Laboratory/Research/Testing facility). Phase: Human Pharmacology (Phase I)- Other. Countries: Netherlands (ended).
Therapeutic area(s): Diseases [C] - Cardiovascular Diseases [C14]
Gender: Male. Age: 18-64 years. Enrolment: 30.
Status: Ended. Start date (EU): 2025-02-26. End date (EU): 2025-07-16. Decision date: 2025-01-28. Results received: No. Last updated: 2025-01-28.

Condition(s): Cardiovascular and metabolic diseases

Source: https://euclinicaltrials.eu/ctis-public/view/2024-519014-31-00